EU clinical trial 2023-508147-43-00: Avoiding Risks of Thrombosis and bleeding in Surgery (ARTS): an international randomised controlled trial evaluating apixaban versus no anticoagulation in patients undergoing general abdominal, gynecologic and urologic surgery
Protocol code: CLUE-ARTS-2023
Sponsor: HUS-yhtymae (Hospital/Clinic/Other health care facility). Phase: Therapeutic use (Phase IV). Countries: Finland (ongoing, recruiting).
Therapeutic area(s): Analytical, Diagnostic and Therapeutic Techniques and Equipment [E] - Therapeutics [E02]
Gender: Female, Male. Age: 18-64 years, 65+ years. Enrolment: 1000.
Status: Ongoing, recruiting. Start date (EU): 2024-05-31. Decision date: 2024-04-10. Results received: No. Last updated: 2025-09-03.

Condition(s): Venous thromboembolism (in surgical patients)
Product: APIXABAN

Primary endpoint: Incidence composite outcome of venous thromboembolism (VTE), defined as symptomatic deep vein thrombosis (DVT), or symptomatic non-fatal or fatal pulmonary embolism (PE) (at 90 days)
Endpoint(s): Incidence of symptomatic DVT (at 90 days), Incidence of symptomatic non-fatal or fatal PE (at 90 days), Safety outcome 1. Incidence of composite endpoint for major bleeding, defined as bleeding leading to a postoperative hemoglobin <70 g/L, transfusion of ≥1 unit of red blood cells, or bleeding that was judged to be the immediate cause of death (at 90 days), Safety outcome 2. Incidence of bleeding requiring re-intervention or endovascular embolization to stop bleeding (at 90 days), Other/Tertiary Outcome 1. Incidence of composite outcome of VTE, defined as symptomatic DVT, or symptomatic non-fatal or fatal PE (at 30 days), Other/Tertiary Outcome 2. Incidence of composite endpoint for major bleeding, defined as bleeding leading to a postoperative hemoglobin <70 g/L, transfusion of ≥1 unit of red blood cells, or bleeding that was judged to be the immediate cause of death (at 30 days), Other/Tertiary Outcome 3. Incidence of bleeding requiring re-intervention or endovascular embolization to stop bleeding (at 30 days), Other/Tertiary Outcome 4. Incidence of symptomatic non-fatal PE (at 90 days), Other/Tertiary Outcome 5. Incidence of symptomatic fatal PE (at 90 days), Other/Tertiary Outcome 6. Incidence of bleeding leading to a postoperative hemoglobin <70 g/L (at 90 days), Other/Tertiary Outcome 7. Incidence of transfusion of ≥1 unit of red blood cells (at 90 days), Other/Tertiary Outcome 8. Incidence of bleeding that was judged to be the immediate cause of death (at 90 days), Other/Tertiary Outcome 9. Incidence of bleeding requiring re-intervention to stop bleeding (at 90 days), Other/Tertiary Outcome 10. Incidence of bleeding requiring endovascular embolization to stop bleeding (at 90 days), Other/Tertiary Outcome 11. Overall mortality (at 90 days), Other/Tertiary Outcome 12. Suspected unexpected serious adverse reactions (SUSARs) potentially related to the study drug (apixaban) (at 90 days), Other/Tertiary Outcome 13. Serious Adverse Events (SAEs), any (at 90 days) • Any potentially drug-related SAEs, cardiac complications (serious), cerebral complications (serious), infectious complications (serious), admittance to intensive care, reoperation or other intervention for other reason than bleeding and other complication, details available at the CRF, Other/Tertiary Outcome 14. Critical organ bleeding (at 90 days) • Intracranial, intraocular, intraspinal, pericardial, retroperitoneal, intra-articular, and/or intramuscular bleeding with compartment syndrome, Other/Tertiary Outcome 15. Cost-effectiveness of DOAC administration (at 90 days)

Source: https://euclinicaltrials.eu/ctis-public/view/2023-508147-43-00